EU clinical trial 2025-521004-21-00: A study to evaluate the safety and tolerability of JNJ-90106848 and to investigate how long JNJ-90106848 stays in and acts on the body (pharmacokinetics) and how the body responds to JNJ-90106848 (pharmacodynamics) when injected into healthy volunteer participants
Protocol code: 90106848EDI1001
Sponsor: Janssen Cilag International (Pharmaceutical company). Phase: Human Pharmacology (Phase I)- First administration to humans. Countries: Belgium (ongoing, recruitment ended).
Therapeutic area(s): Diseases [C] - Immune System Diseases [C20]
Gender: Female, Male. Age: 18-64 years. Enrolment: 63.
Status: Ongoing, recruitment ended. Start date (EU): 2025-08-21. Decision date: 2025-08-11. Results received: No. Last updated: 2026-02-11.

Condition(s): Inflammatory Conditions

Source: https://euclinicaltrials.eu/ctis-public/view/2025-521004-21-00